EU clinical trial 2025-523869-22-00: A Phase III, multi-center, open-label, randomised, controlled trial of intravenous obrixtamig in combination with carboplatin and etoposide vs. carboplatin and etoposide as first-line therapy in DLL3-positive patients with unresectable locally advanced or metastatic extrapulmonary neuroendocrine carcinomas.
Protocol code: 1438-0011
Sponsor: Boehringer Ingelheim International GmbH, Boehringer Ingelheim Espana S.A. (Pharmaceutical company). Phase: Therapeutic confirmatory (Phase III). Countries: Portugal (ongoing, recruiting), Spain (authorised, recruitment pending), Poland (authorised, recruitment pending), Sweden (authorised, recruitment pending), Italy (authorised, recruitment pending), Czechia (authorised, recruitment pending), France (ongoing, recruiting), Netherlands (authorised, recruitment pending), Finland (authorised, recruitment pending), Denmark (authorised, recruitment pending), Austria (authorised, recruitment pending), Germany (authorised, recruitment pending), Belgium (ongoing, recruiting), Norway (authorised, recruitment pending).
Therapeutic area(s): Diseases [C] - Neoplasms [C04]
Gender: Female, Male. Age: 18-64 years, 65+ years. Enrolment: 144.
Start date (EU): 2026-07-09. Decision date: 2026-05-13. Results received: No. Last updated: 2026-08-06.
Decision dates by country: AT: 2026-05-17, DK: 2026-05-13, DE: 2026-05-15, IT: 2026-05-13, SE: 2026-05-18, NO: 2026-05-13, PL: 2026-05-15, NL: 2026-06-08, FI: 2026-05-15, BE: 2026-06-12, CZ: 2026-05-14, FR: 2026-05-15, PT: 2026-05-14, ES: 2026-05-13

Condition(s): advanced or metastatic extrapulmonary neuroendocrine carcinoma
Product: Avtozma 20 mg/mL concentrate for solution for infusion., Carboplatin Hikma 10 mg/ml Konzentrat zur Herstellung einer Infusionslösung, Etoposid Hikma 20 mg/ml Konzentrat zur Herstellung einer Infusionslösung, BI 764532

Primary endpoint: Overall survival (OS), defined as the time from randomisation until death from any cause
Endpoint(s): PFS is defined as the time from randomisation until the earliest date of disease progression according to RECIST 1.1 based on investigator assessments or death from any cause, whichever occurs first, Change from baseline to Week 19 in the physical functioning domain of the EORTC QLQ-C30, Objective response (OR) is defined as a best overall response of complete response (CR) or partial response (PR) according to RECIST 1.1 (based on investigator assessments) from randomisation until the earliest date of disease progression, death, last evaluable tumour assessment before the start of next line of anti-cancer treatment, loss to follow-up, or withdrawal of consent, DoR, defined as the time from the first documented OR according to RECIST 1.1 until the earliest date of disease progression or death among patients with objective response based on investigator assessments, Disease control (DC), defined as best overall response of complete response (CR) or partial response (PR) or stable disease (SD) where best overall response is defined according to RECIST 1.1 based on investigator assessments from randomisation until the earliest of disease progression, death or last evaluable tumour assessment before start of next line of anti-cancer treatment, loss to follow-up or withdrawal of consent, Occurrence of treatment-emergent Grade 3 or greater CRS, Occurrence of treatment-emergent Grade 3 or greater ICANS, Occurrence of treatment-emergent AEs leading to permanent discontinuation of trial medication during the on-treatment period, Occurrence of treatment-emergent AEs leading to dose modification of trial medication (i.e. dose interruption, dose delay, dose reduction)

Source: https://euclinicaltrials.eu/ctis-public/view/2025-523869-22-00